EU clinical trial 2022-500311-39-00: Prevention of postoperative endoscopic recurrence with endoscopy-driven versus systematic biological therapy: a randomized, multicentre, parallel group pragmatic non-inferiority trial in adult patients with Crohn’s disease undergoing an ileocolonic resection with ileocolonic anastomosis
Protocol code: S62015
Sponsor: UZ Leuven (Hospital/Clinic/Other health care facility). Phase: Therapeutic use (Phase IV). Countries: Belgium (ongoing, recruiting), Italy (ongoing, recruiting).
Therapeutic area(s): Diseases [C] - Digestive System Diseases [C06]
Gender: Female, Male. Age: 18-64 years, 65+ years. Enrolment: 352.
Status: Ongoing, recruiting. Start date (EU): 2022-09-08. Decision date: 2022-06-21. Results received: No. Last updated: 2026-03-26.
Decision dates by country: BE: 2022-07-20, IT: 2022-09-15

Condition(s): Patients with Crohn's disease undergoing surgery and having at least one risk factor for postoperative recurrence of the disease.
Product: RISANKIZUMAB, Tremfya 200 mg solution for injection in pre-filled syringe, ADALIMUMAB, Tremfya 100 mg solution for injection in pre-filled syringe., ADALIMUMAB, RISANKIZUMAB, ADALIMUMAB, INFLIXIMAB, INFLIXIMAB, Omvoh 100 mg + 200 mg solution for injection in pre-filled syringe, USTEKINUMAB, VEDOLIZUMAB, VEDOLIZUMAB, VEDOLIZUMAB, Tremfya 200 mg concentrate for solution for infusion, USTEKINUMAB, Omvoh 300 mg concentrate for solution for infusion

Primary endpoint: Endoscopic recurrence (updated Rutgeerts score ≥i2b) at week 86 or need for unscheduled treatment adaptation prior to week 86.
Endpoint(s): Endoscopic recurrence (updated Rutgeerts score ≥i2b) at week 86., Harvey-Bradshow index (HBI) based clinical recurrence prior to week 86., Direct costs from Baseline to week 86., Need for a new ileocolonic resection prior to week 86., Severe adverse reactions to biological therapy prior to week 86., Serious adverse events prior to week 86., Quality of life (EQ-5D 5L) at week 30, week 62 and week 86 in comparison to Baseline., Crohn’s disease activity index (CDAI) based clinical recurrence at week 86., CDAI based clinical recurrence prior to week 86., Time to CDAI based clinical recurrence., HBI based clinical recurrence at week 86., Time to HBI based clinical recurrence., PRO-2 based clinical recurrence at week 86., PRO-2 based clinical recurrence prior to week 86., Time to PRO-2 clinical recurrence., Endoscopic disease activity (≥i3, ≥i2a, or ≥i1) at week 86., Endoscopic recurrence at week 30 (updated Rutgeerts score ≥i2b)., Endoscopic disease activity (≥i3, ≥i2a, or ≥i1) at week 30, Persistent endoscopic recurrence at week 86 after development of endoscopic recurrence at week 30., Need for a new ileocolonic resection, a balloon dilation or a strictureplasty at the site of the ileocolonic anastomosis prior to week 86., Work productivity and activity impairment (WPAI:CD) at week 30, week 62 and week 86 in comparison to Baseline., Change in medical therapy for Crohn’s disease prior to week 86., Change in C-reactive protein (CRP) at week 14, week 30, week 46, week 62, and week 86 in comparison to Baseline., Change in faecal calprotectin at week 14, week 30, week 46, week 62, and week 86 in comparison to Baseline., Number of unscheduled visits related to CD (clinical visit, endoscopic or radiological evaluation)., Suspected unexpected serious adverse reactions prior to week 86., Predictors of clinical, biological, endoscopic, and surgical outcome prior to week 86., Evolution of CDAI, HBI and PRO-2 at week 138, 190 and 242 in comparison to Baseline and Week 86., Evolution of EQ-5D 5L at week 138, 190 and 242 in comparison to Baseline and Week 86., Evolution of WPAI:CD at week 138, 190 and 242 in comparison to Baseline and Week 86., Evolution of CRP at week 138, 190 and 242 in comparison to Baseline and Week 86., Evolution of faecal calprotectin at week 138, 190 and 242 in comparison to Baseline and Week 86., Change in medical therapy for Crohn’s disease prior to week 138, 190 and 242., Need for a new ileocolonic resection prior to week 138, 190 and 242., Need for a new ileocolonic resection, a balloon dilation or a strictureplasty at the site of the ileocolonic anastomosis prior to week 138, 190 and 242., Serious adverse reactions to biological therapy prior to week 138, 190 and 242, Serious adverse events prior to week 138, 190 and 242., Suspected unexpected serious adverse reactions prior to week 138, 190 and 242, Predictors of clinical, biological, endoscopic, and surgical outcome prior to week 138, 190 and 242., Building a risk score at Baseline that is predictive for endoscopic, biological, clinical and surgical recurrence., Evaluating whether macroscopic or microscopic involvement (including presence of granulomas) of the proximal resection margin at index surgery is predictive of endoscopic, biological, clinical and surgical recurrence., Evaluating the association between the use of GLP-1 agonists (e.g. semaglutide and tirzepatide) at Baseline and endoscopic, biological, clinical and surgical recurrence at week 30 and 86., Evaluating the association between vaping or the use of e-cigarettes at Baseline and endoscopic, biological, clinical and surgical recurrence at week 30 and 86., Evaluating the association between the use of GLP-1 agonists (e.g. semaglutide and tirzepatide) at Baseline and endoscopic, biological, clinical and surgical recurrence at week 138, 190 and 242, Evaluating the association between vaping or the use of e-cigarettes at Baseline and endoscopic, biological, clinical and surgical recurrence at week 138, 190 and 242

Source: https://euclinicaltrials.eu/ctis-public/view/2022-500311-39-00